EU clinical trial 2023-506590-35-00: FIRST-NEC (GFPC 01-2022) - A multicenter phase II study evaluating the efficacy and safety of the combination of durvalumab with etoposide and platinum as first line treatment in patients with large-cell neuroendocrine carcinomas (LCNECs) of the lung
Protocol code: ET23-132
Sponsor: Centre Leon Berard (Hospital/Clinic/Other health care facility). Phase: Therapeutic exploratory (Phase II). Countries: France (ongoing, recruiting).
Therapeutic area(s): Diseases [C] - Neoplasms [C04]; Diseases [C] - Respiratory Tract Diseases [C08]
Gender: Female, Male. Age: 18-64 years, 65+ years. Enrolment: 80.
Status: Ongoing, recruiting. Start date (EU): 2024-06-13. Decision date: 2024-03-14. Results received: No. Last updated: 2026-04-16.

Condition(s): Large-Cell NeuroEndocrine Carcinoma of the lung, locally advanced (Stage III) not eligible for loco-regional therapy or metastatic (Stage IV) in first line treatment
Product: CARBOPLATIN, ETOPOSIDE, IMFINZI 50 mg/mL concentrate for solution for infusion., CISPLATIN

Primary endpoint: Progression-Free Rate at 12 months

Source: https://euclinicaltrials.eu/ctis-public/view/2023-506590-35-00